EU clinical trial 2022-501988-40-00: A Phase III, open-label, randomized, controlled, multi-country study to evaluate the immune response, safety and reactogenicity of RSVPreF3 OA investigational vaccine when co-administered with 20-valent pneumococcal conjugate vaccine (PCV20) in adults aged 60 years and older.
Protocol code: 219276
Sponsor: GlaxoSmithKline Biologicals (Pharmaceutical company). Phase: Therapeutic confirmatory (Phase III). Countries: Spain (ended), Belgium (ended), Poland (ended).
Therapeutic area(s): Diseases [C] - Virus Diseases [C02]
Gender: Female, Male. Age: 18-64 years, 65+ years. Enrolment: 407.
Status: Ended. Start date (EU): 2023-08-17. End date (EU): 2024-05-07. End date: 2024-05-08. Decision date: 2023-07-17. Results received: Yes. Last updated: 2024-03-25.
Decision dates by country: BE: 2023-07-17, ES: 2023-07-24, PL: 2023-07-24

Condition(s): RSV-associated (subtypes A and B) disease in adults aged 60 years of age and older.
Product: Apexxnar suspension for injection in pre-filled syringe Pneumococcal polysaccharide conjugate vaccine (20-valent, adsorbed)

Primary endpoint: • Opsonophagocytic (OP) antibody (Ab) titers for each of the pneumococcal vaccine serotype (ST) expressed as between groups geometric mean titer (GMT) ratio, 1 month after the PCV20 dose., • RSV-A neutralizing Ab titers expressed as between groups GMT ratio, 1 month after the RSVPreF3 OA investigational vaccine dose., • RSV-B neutralizing Ab titers expressed as between groups GMT ratio, 1 month after the RSVPreF3 OA investigational vaccine dose.
Endpoint(s): • RSV-A neutralizing Ab titers expressed as mean geometric increase (MGI) over baseline at 1 month after the RSVPreF3 OA investigational vaccine dose., • RSV-B neutralizing Ab titers expressed as MGI over baseline at 1 month after the RSVPreF3 OA investigational vaccine dose., • Percentage of participants reporting each solicited event with onset within 7 days after vaccine administration (i.e., the day of vaccination and 6 subsequent days), • Percentage of participants reporting unsolicited AE within 30 days after vaccine administration (i.e., the day of vaccination and 29 subsequent days), • Percentage of participants reporting SAEs after vaccine administration (Day 1) up to EoS (6 months after last vaccination)., • Percentage of participants reporting pIMDs after vaccine administration (Day 1) up to EoS (6 months after last vaccination).

Source: https://euclinicaltrials.eu/ctis-public/view/2022-501988-40-00